EU clinical trial 2022-501124-23-00: « Effect of sedative and anxiolytic sedation on children experience after general anesthesia » PEDIA_prem study.
Protocol code: RECHMPL21_0354
Sponsor: Centre Hospitalier Universitaire De Montpellier (Hospital/Clinic/Other health care facility). Phase: Therapeutic confirmatory (Phase III). Countries: France (ongoing, recruiting).
Therapeutic area(s): Analytical,Diagnostic,Therapeutic Techniques and Equipment [E]-Surgical Procedures, Operative [E04]; Analytical, Diagnostic and Therapeutic Techniques and Equipment [E] - Anesthesia and Analgesia [E03]
Gender: Female, Male. Age: 0-17 years. Enrolment: 1000.
Status: Ongoing, recruiting. Start date (EU): 2023-04-18. Decision date: 2022-10-14. Results received: No. Last updated: 2026-07-15.

Condition(s): General anesthesia and sedative and anxiolytic sedation
Product: DEXMEDETOMIDINE EVER PHARMA 100 microgrammes/mL, solution à diluer pour perfusion, MIDAZOLAM VIATRIS 5 mg/ml, solution injectable ou rectale, the placebo will be the grenadine syrup that is usually used in anesthesia and resuscitation departments.

Primary endpoint: The primary endpoint was the EVANpedia perioperative experience score and its sub-dimensions completed by the children (self-report) at 24 hours postoperatively or before hospital discharge for children managed as outpatients.
Endpoint(s): Perioperative anxiety, Haemodynamic changes (Tachycadia, Bradycardia hypotension) during intervention, postoperative pain, Sedation and time to extubation, Rate of recovery, Amnesia and cognitive impairment, Changes of behavioral, All perioperative complications between the 3 groups, Quality of life

Source: https://euclinicaltrials.eu/ctis-public/view/2022-501124-23-00